EU clinical trial 2023-504824-24-00: A Study to Evaluate Safety and Preliminary Anti-tumor Activity of Debio 0123 as Monotherapy in Adult Participants With Advanced Solid Tumors
Protocol code: Debio 0123-102
Sponsor: Debiopharm International S.A. (Pharmaceutical company). Phase: Human Pharmacology (Phase I)- Other. Countries: Spain (ended).
Therapeutic area(s): Diseases [C] - Neoplasms [C04]
Gender: Female, Male. Age: 18-64 years, 65+ years. Enrolment: 47.
Status: Ended. Start date (EU): 2024-03-15. End date (EU): 2026-03-31. End date: 2026-04-24. Decision date: 2024-02-21. Results received: No. Last updated: 2025-12-01.

Condition(s): Arm A: Diagnosed with uterine serous carcinoma (USC); Arm B: Diagnosed with recurrent or progressive, high-grade epithelial ovarian cancer (EOC) with cyclin E1-driven selection; Arm C: Diagnosed with solid tumor with biomarker-driven selection

Source: https://euclinicaltrials.eu/ctis-public/view/2023-504824-24-00